EU clinical trial 2025-520775-81-00: A 104-week, multicenter, open-label, single-arm, phase 3 extension trial investigating the long-term safety and efficacy of Glepaglutide in adult patients with short bowel syndrome (SBS) rolling over from the EASE SBS 2 or 3 trials
Protocol code: ZP1848-25009
Sponsor: Zealand Pharma A/S (Pharmaceutical company). Phase: Therapeutic confirmatory (Phase III). Countries: Poland (ongoing, recruitment ended), France (ongoing, recruitment ended), Germany (ongoing, recruitment ended), Belgium (ongoing, recruitment ended).
Therapeutic area(s): Diseases [C] - Digestive System Diseases [C06]
Gender: Female, Male. Age: 18-64 years, 65+ years. Enrolment: 19.
Status: Ongoing, recruitment ended. Start date (EU): 2025-12-23. Decision date: 2025-11-26. Results received: No. Last updated: 2026-06-08.
Decision dates by country: BE: 2025-12-15, DE: 2025-11-26, FR: 2025-12-15, PL: 2026-01-04

Condition(s): Short Bowel Syndrome
Product: Glepaglutide 20.0 mg/mL

Primary endpoint: TEAEs from baseline (Visit 1) to the safety follow-up visit
Endpoint(s): Change in prescribed weekly PS volume from baseline to Month 24/EOT

Source: https://euclinicaltrials.eu/ctis-public/view/2025-520775-81-00